EU clinical trial 2024-515971-37-00: Phase II, Single-arm Clinical Trial Evaluating Efficacy and Safety of Pembrolizumab in Combination With a Soluble LAG-3 Protein, Eftilagimod Alpha, and Radiotherapy in Neoadjuvant Treatment of Patients With Soft Tissue Sarcomas (EFTISARC-NEO)
Protocol code: EFTISARC-NEO/NIO0004
Sponsor: Narodowy Instytut Onkologii Im. Marii Sklodowskiej-Curie Panstwowy Instytut Badawczy (Hospital/Clinic/Other health care facility). Phase: Therapeutic exploratory (Phase II). Countries: Poland (ongoing, recruitment ended).
Therapeutic area(s): Diseases [C] - Neoplasms [C04]
Gender: Female, Male. Age: 18-64 years, 65+ years. Enrolment: 40.
Status: Ongoing, recruitment ended. Start date (EU): 2023-07-17. Decision date: 2024-10-30. Results received: No. Last updated: 2026-02-12.

Condition(s): Resectable soft tissue sarcomas
Product: KEYTRUDA 25 mg/mL concentrate for solution for infusion, IMP321

Primary endpoint: The pathological response, defined as percentage of fibrosis and hyalinization found in the surgical specimen after completion of preoperative treatment.
Endpoint(s): Treatment safety profile, Number of patients completing neoadjuvant treatment and having a curative surgery according to the protocol., Disease-free survival time (DFS), Local recurrence-free survival (LRFS), Distant metastasis-free survival (DMFS), Overall survival (OS), Overall response rate (ORR) by RECIST 1.1 criteria, Exploratory endpoints include the search for biomarkers and correlations between their occurrence and response to treatment

Source: https://euclinicaltrials.eu/ctis-public/view/2024-515971-37-00